EU clinical trial 2023-505334-10-01: Phase 1/2 study testing for the first time in humans a novel drug, STAR0602, to selectively stimulate T cells for the treatment of subjects with advanced solid tumors that cannot be removed with surgery or has spread locally or to other parts of the body.
Protocol code: CP-START-001
Sponsor: Marengo Therapeutics Inc. (Pharmaceutical company). Phase: Phase I and Phase II (Integrated)- First administration to humans. Countries: France (ongoing, recruiting), Spain (ongoing, recruiting).
Therapeutic area(s): Diseases [C] - Neoplasms [C04]
Gender: Female, Male. Age: 18-64 years, 65+ years. Enrolment: 80.
Status: Ongoing, recruiting. Start date (EU): 2024-10-30. Decision date: 2024-07-08. Results received: No. Last updated: 2026-05-25.
Decision dates by country: ES: 2024-07-12, FR: 2024-07-08

Condition(s): Unresectable, Locally Advanced, or Metastatic Solid Tumors

Source: https://euclinicaltrials.eu/ctis-public/view/2023-505334-10-01